EU clinical trial 2023-508996-35-00: A randomized, two-period crossover study to demonstrate the comparability of pharmacokinetics of subcutaneous ianalumab between 2mL auto-injector/2mL pre-filled syringe with 1 mL pre-filled syringe in adult participants with autoimmune disease
Protocol code: CVAY736A2202
Sponsor: Novartis Pharma AG (Pharmaceutical company). Phase: Therapeutic exploratory (Phase II). Countries: Czechia (ongoing, recruitment ended), Netherlands (ended), Poland (ongoing, recruitment ended), Hungary (ongoing, recruitment ended), Spain (ongoing, recruitment ended), Italy (ongoing, recruitment ended), Germany (ended).
Therapeutic area(s): Diseases [C] - Immune System Diseases [C20]
Gender: Female, Male. Age: 18-64 years, 65+ years. Enrolment: 69.
Start date (EU): 2024-11-18. Decision date: 2024-09-17. Results received: No. Last updated: 2026-07-29.
Decision dates by country: NL: 2024-09-18, DE: 2024-09-19, IT: 2024-09-18, PL: 2024-09-22, CZ: 2024-09-17, ES: 2024-09-18, HU: 2024-09-17

Condition(s): Systemic Lupus erythematosus, Sjögren’s Disease, Rheumatoid Arthritis
Product: TENOFOVIR DISOPROXIL, VAY736, TENOFOVIR ALAFENAMIDE, VAY736, VAY736, ENTECAVIR

Primary endpoint: For each cohort, Ianalumab serum concentrations (AUCtau and Cmax) over a dosing interval after 3rd (between Week 8 and 12) and 6th dose (between Week 20 and 24)
Endpoint(s): For each cohort, ianalumab PK parameters will be determined: Tmax and Ctrough, Adverse events, laboratory evaluations, vital signs, ECG parameters, Anti-ianalumab antibodies (ADA); incidence of ADA positive participants

Source: https://euclinicaltrials.eu/ctis-public/view/2023-508996-35-00